EU clinical trial 2024-515780-62-00: A single center, open-label pilot study in healthy subjects using dermal open flow microperfusion to collect body fluids for bioanalytical matrix validation and to explore the effects of topical product removal on dermal kinetics
Protocol code: FDA03A1
Sponsor: Medical University Of Graz (Educational Institution). Phase: Human Pharmacology (Phase I)- Other. Countries: Austria (ended).
Therapeutic area(s): Not possible to specify
Gender: Female, Male. Age: 18-64 years. Enrolment: 10.
Status: Ended. Start date (EU): 2025-02-05. End date (EU): 2025-07-03. Decision date: 2024-11-18. Results received: Yes. Last updated: 2025-06-02.

Condition(s): No medical condition is being investigated in this clinical trial.
Product: METRONIDAZOLE

Primary endpoint: Dermal PK profile (drug concentration over time) for defined removal times, Dermal PK parameter (e.g. AUC, Cmax, tmax) for defined removal times, Serum PK profile (drug concentration over time)

Source: https://euclinicaltrials.eu/ctis-public/view/2024-515780-62-00